EU clinical trial 2024-514988-25-00: Phase 1/2 UMBRELLA trial evaluating isatuximab with or without dexamethasone in combination with novel agents in relapsed or refractory multiple myeloma (RRMM) - Master protocol; Phase 1/2 trial evaluating isatuximab with or without dexamethasone in combination with novel agents compared to isatuximab with pomalidomide and dexamethasone in relapsed or refractory multiple myeloma (RRMM) - control arm
Protocol code: ACT16482-01
Sponsor: Sanofi-Aventis Recherche & Developpement (Pharmaceutical company). Phase: Phase I and Phase II (Integrated)- Other. Countries: France (ongoing, recruiting), Portugal (ended), Norway (ongoing, recruiting), Italy (ongoing, recruiting), Germany (ongoing, recruiting), Greece (ongoing, recruiting).
Therapeutic area(s): Diseases [C] - Neoplasms [C04]
Gender: Female, Male. Age: 18-64 years, 65+ years. Enrolment: 7.
Start date (EU): 2021-03-31. Decision date: 2024-10-11. Results received: No. Last updated: 2026-05-04.
Decision dates by country: IT: 2024-10-16, NO: 2024-10-16, PT: 2024-10-14, FR: 2024-10-17, GR: 2024-10-11, DE: 2024-10-11

Condition(s): Cancer
Product: Imnovid 4 mg hard capsules, JAMP Pomalidomide, Pomalidomide Adalvo 3 mg hard capsules, Imnovid 1 mg hard capsules, Imnovid 4 mg hard capsules, Pomalidomide Adalvo 1 mg hard capsules, Imnovid 2 mg hard capsules, JAMP Pomalidomide, Imnovid 1 mg hard capsules, JAMP Pomalidomide, Dexamethason 4 mg JENAPHARM®, Imnovid 3 mg hard capsules, Pomalidomide Adalvo 4 mg hard capsules, Pomalidomide Adalvo 2 mg hard capsules, Dexamethason 8 mg JENAPHARM®, Isatuximab, Isatuximab, JAMP Pomalidomide, Imnovid 3 mg hard capsules, Imnovid 2 mg hard capsules

Primary endpoint: Part 1 (dose finding, experimental substudies): Determination of recommended dose of novel agents in combination with isatuximab- Master only, Part 2 (expansion, controlled experimental substudies): VGPR Rate (Rate of Very Good Partial Response Rate or Better), Part 2 (expansion, independent experimental substudies): Overall Response Rate (ORR) in independent experimental substudies
Endpoint(s): Part 1 (dose finding, experimental substudies): ORR – Master only, Part 2 (expansion, controlled experimental substudies): ORR, Part 1 (dose finding, experimental substudies): VGPR or better – Master only, Part 2 (expansion, independent experimental substudies): VGPR or better, Clinical Benefit Rate (CBR) in each treatment arm, Duration of Response (DOR) in each treatment arm, Time to First Response (TT1R) in each treatment arm, Time to Best Response (TTBR) in each treatment arm, Number of participants with treatment emergent adverse events and serious adverse events in each treatment arm, Progression-free survival (PFS) in each treatment arm, Overall Survival (OS) in each treatment arm, Immunogenicity of isatuximab and novel agents, Concentration of novel agents (experimental arms) and isatuximab (Ctrough), Disease-specific HRQL will be assessed using the European Organization for Research and Treatment of Cancer (EORTC) core quality of life questionnaire (QLQ-C30), Disease and treatment-related quality of life will be assessed using the EORTC multiple myeloma module (QLQ-MY20) questionnaire, Global impact of side effects will be assessed using the Functional Assessment of Cancer Therapy (FACT-G) (GP5), Estimate/Confirm established clinically meaningful change scores for clinical outcome assessments (COAs)/domain scores using the Patient Global Impression of Severity (PGIS) and Patient Global Impression of Change (PGIC) scales.

Source: https://euclinicaltrials.eu/ctis-public/view/2024-514988-25-00